EU clinical trial 2024-516215-24-00: STARS - Prospective, bayesian, randomized, controlled, open-label, parallel-group, phase II interventional study evaluating efficacy and safety of secukinumab versus standard of care in active severe Takayasu patients
Protocol code: APHP 240614
Sponsor: Assistance Publique Hopitaux De Paris (Hospital/Clinic/Other health care facility). Phase: Therapeutic exploratory (Phase II). Countries: France (ongoing, recruiting).
Therapeutic area(s): Diseases [C] - Immune System Diseases [C20]
Gender: Female, Male. Age: 0-17 years, 18-64 years, 65+ years. Enrolment: 52.
Status: Ongoing, recruiting. Start date (EU): 2026-07-01. Decision date: 2026-02-26. Results received: No. Last updated: 2026-03-12.

Condition(s): TAkayasu ARteritiS
Product: INFLIXIMAB, TOCILIZUMAB, Cosentyx 300 mg solution for injection in pre-filled pen, ADALIMUMAB

Primary endpoint: Disease remission (defined by NIH score ≤ 1) at 6 months and with prednisone discontinuation Disease activity is measured according to National Institutes of Health (NIH) criteria (Kerr 1994) and comprises four variables, each scoring one point as below (scale range 0-4 points). A score equal or superior to 2 is considered as active disease., • Criterion 1 scores if at least one of the following systemic characteristics, without any other cause identified: o Constitutional symptoms such as low-grade fever, weight loss and fatigue; o Extra-vascular manifestations (e.g., polyarthralgia / arthritis, erythema nodosum, episcleritis, etc)., • Criterion 2 scores if at least one of the following clinical signs have appeared since the previous visit: o New carotidodynia, vascular claudication or pain along an arterial pathway o New transient ischemic attack (TIA), stroke, acute coronary syndrome or instable angina o New pulse loss o New vascular bruit o New anisotension, • Criterion 3 scores if at least one of the following biological inflammatory markers are elevated in the absence of any other reason: o Erythrocyte sedimentation rate at 1 hour > 30 mm/h ; o C-reactive protein > 10 mg/L ; o Fibrinogen > 4 g/L., • Criterion 4 scores if at least one of the following radiological signs appears in a otherwise unaffected arterial territory: o New arterial wall thickening with wall contrast enhancement in vascular imaging Appearance of new vascular lesions (e.g., New arterial wall thickening stenosis, aneurysms) in Doppler, MRA, computed tomography angiography (CTA) or new hypermetabolism in 18-Fluorodeoxyglucose positron emission tomography/computed tomography (18-FDG-PET).
Endpoint(s): Cumulative incidence of relapse over the 12 months after initiation of experimental treatment, Cumulative incidence of treatment failure over the 12 months after initiation of experimental therapy, Cumulative prednisone dose over the 12 months after initiation of experimental treatment, Glucocorticoid-free disease remission will be assessed at 3, 6, and 12 months using the primary composite endpoint, Cumulative incidence of AE and SAE over the 12 months after initiation of investigational therapy, Change in the Physical Component Summary (PCS) of the SF36 between the start of experimental treatment,6 and 12 months after, Change in vascular lesions at 3, 6, and 12 months after the start of experimental treatment, measured by angio CT and/or magnetic resonance imaging angiography and/or Doppler, Change in vascular hypermetabolism at 6 and 12 months after the start of experimental treatment, measured by 18-FDG-PET, - Cumulative incidence of revascularization procedures (endovascular or surgical) required because of disease at 6 and 12 months after initiation of experimental therapy.

Source: https://euclinicaltrials.eu/ctis-public/view/2024-516215-24-00